EU clinical trial 2023-509061-20-00: A Phase 1/2 Study of BMS-986253 in Combination with Nivolumab or Nivolumab plus Ipilimumab in Advanced Cancers
Protocol code: CA027-002
Sponsor: Bristol Myers Squibb International Corporation (Pharmaceutical company). Phase: Phase I and Phase II (Integrated)- Other. Countries: Italy (ended), Germany (ended), Spain (ended), Belgium (ended), Poland (ended), France (ended).
Therapeutic area(s): Diseases [C] - Neoplasms [C04]
Gender: Female, Male. Age: 18-64 years, 65+ years. Enrolment: 113.
Status: Ended. Start date (EU): 2018-11-22. End date (EU): 2025-12-04. End date: 2025-12-05. Decision date: 2024-03-20. Results received: No. Last updated: 2025-12-23.
Decision dates by country: BE: 2024-03-21, PL: 2024-03-29, FR: 2024-03-25, DE: 2024-03-25, IT: 2024-03-20, ES: 2024-03-20

Condition(s): Advanced solid tumors
Product: anti-IL8 mAb, Ipilimumab, anti-IL8 mAb, 5% dextrose solution for injection, OPDIVO 10 mg/mL concentrate for solution for infusion., Ipilimumab, 0.9% sodium chloride solution for injection

Primary endpoint: Safety: Number and severity of side effects in patients treated with BMS-986253 administered with other medications., Efficacy: Effectiveness of treatment measured by formal response criteria.
Endpoint(s): The amount of drug present in the body after one or more doses of BMS-986253 administered in combination with other medications., The amount of IL-8 in blood, The length of time during and after treatment that a patient lives with the disease but it does not get worse

Source: https://euclinicaltrials.eu/ctis-public/view/2023-509061-20-00